EU clinical trial 2024-516271-32-00: RACE-trial: Neoadjuvant Radiochemotherapy versus Chemotherapy for Patients with Locally Advanced, Potentially Resectable Adenocarcinoma of the Gastroesophageal Junction (GEJ) A randomized phase III joint study of the AIO, ARO and DGAV
Protocol code: RACE
Sponsor: Universitat Heidelberg (Educational Institution). Phase: Therapeutic confirmatory (Phase III). Countries: Germany (ended).
Therapeutic area(s): Diseases [C] - Neoplasms [C04]
Gender: Female, Male. Age: 18-64 years, 65+ years. Enrolment: 342.
Status: Ended. Start date (EU): 2020-06-03. End date (EU): 2026-06-30. Decision date: 2024-11-12. Results received: No. Last updated: 2024-11-12.

Condition(s): Adenocarcinoma of the gastroesophageal junction (AEG type I-III)
Product: FLUOROURACIL, DOCETAXEL, OXALIPLATIN, CALCIUM FOLINATE

Primary endpoint: Progression-free survival (PFS)
Endpoint(s): Overall survival, including survival rates after 1, 3 and 5 years, R0 resection rate, Number of harvested lymph nodes, Site of tumor relapse, Perioperative morbidity and mortality rate, Safety and toxicity as assessed by NCI CTC criteria, Quality of life by using the EORTC QLQ-C30 and the esophagogastric module OG25

Source: https://euclinicaltrials.eu/ctis-public/view/2024-516271-32-00